EU clinical trial 2024-515457-21-00: An Open-Label, Rollover Platform Study for Continued Study Treatment and Ongoing Safety Monitoring
Protocol code: PLATFORMPACAN1001
Sponsor: Janssen Cilag International (Pharmaceutical company). Phase: Human Pharmacology (Phase I)- Other. Countries: Poland (ongoing, recruiting), Greece (ongoing, recruiting), France (ongoing, recruiting), Belgium (ongoing, recruiting), Spain (ongoing, recruiting), Denmark (authorised, recruitment pending).
Therapeutic area(s): Diseases [C] - Neoplasms [C04]
Gender: Female, Male. Age: 65+ years. Enrolment: 69.
Start date (EU): 2024-12-30. Decision date: 2024-12-16. Results received: No. Last updated: 2026-07-20.
Decision dates by country: FR: 2024-12-16, PL: 2024-12-20, GR: 2024-12-17, BE: 2024-12-18, ES: 2025-06-20, DK: 2026-06-30

Condition(s): Non-Hodgkin lymphoma and chronic lymphocytic leukemia

Source: https://euclinicaltrials.eu/ctis-public/view/2024-515457-21-00